EU clinical trial 2025-520686-46-00: Open-label, double-arm, controlled, randomized, multicentre clinical trial to evaluate the impact of pharmacogenetic-guided treatment in patients with insufficiently controlled type 2 diabetes
Protocol code: EPHIC-DIA2
Sponsor: Instituto De Investigacion Sanitaria Fundacion Para La Investigacion Del Hospital Clinico De Valencia-INCLIVA (Hospital/Clinic/Other health care facility). Phase: Therapeutic use (Phase IV). Countries: Spain (ended).
Therapeutic area(s): Diseases [C] - Nutritional and Metabolic Diseases [C18]
Gender: Female, Male. Age: 18-64 years, 65+ years. Enrolment: 504.
Status: Ended. Start date (EU): 2025-05-15. End date (EU): 2026-05-26. Decision date: 2025-04-28. Results received: No. Last updated: 2025-09-15.

Condition(s): Type 2 Diabetes Mellitus
Product: Sitagliptin 50mg Film-coated Tablets, Trajenta 5 mg film-coated tablets, Pioglitazone Mylan 15 mg compresse, Ozempic 0.5 mg solution for injection in pre-filled pen, Jardiance 10 mg film-coated tablets, GLUCOPHAGE 1000 mg potahované tablety, Invokana 100 mg film-coated tablets, Trulicity 1.5 mg solution for injection in pre-filled pen, Galvus 50 mg tablets, Forxiga 10 mg film-coated tablets

Primary endpoint: Proportion of patients achieving goal HbA1c ≤7% at Week 24 in experimental arm versus control arm.
Endpoint(s): Comparison between patients who have achieved the goal of HbA1c ≤7% at baseline (excluded for randomization) with patients who did not (included for the randomization)., Percentage of patients achieving the goal of dyslipidemia at Week 24: - LDL-C of <70 mg/dL without documented CVD at baseline. - LDL-C of <55 mg/dL with documented CVD at baseline., Percentage of patients achieving the goal of blood pressure (<140/90 mmHg) at Week 24., Number of glucose-lowering drugs’ adverse events reported for each genetic variation identified., Proportion of patients in each group presenting each clinical outcome over the study period: • Adverse events (AEs) related to glucose-lowering drugs • Serious Adverse events (SAEs) • Changes in clinical laboratory parameters, including renal and hepatic function. • Changes in vital signs

Source: https://euclinicaltrials.eu/ctis-public/view/2025-520686-46-00